EU clinical trial 2024-517021-12-00: A study to assess the safety and tolerability of next-generation neoantigen-selected Tumor-infiltrating Lymphocyte (TIL) therapy. NEXTGEN-TIL-ACT
Protocol code: VHIO20001
Sponsor: Vall D Hebron Institute Of Oncology (Laboratory/Research/Testing facility). Phase: Human Pharmacology (Phase I)- Other. Countries: Spain (ongoing, recruiting).
Therapeutic area(s): Diseases [C] - Neoplasms [C04]
Gender: Female, Male. Age: 18-64 years, 65+ years. Enrolment: 10.
Status: Ongoing, recruiting. Start date (EU): 2021-10-26. Decision date: 2024-10-21. Results received: No. Last updated: 2026-02-02.

Condition(s): Advanced epithelial tumors and immune checkpoint blockade (ICB) resistant solid tumors

Source: https://euclinicaltrials.eu/ctis-public/view/2024-517021-12-00